EU clinical trial 2025-523648-11-00: A study to learn more about how safe BAY 3771249 is and how well it works in people with advanced or metastatic colorectal cancer that has a KRAS G12D mutation
Protocol code: 23111 & 23111-1
Sponsor: Bayer Consumer Care AG (Pharmaceutical company). Phase: Human Pharmacology (Phase I)- Other. Countries: Finland (authorised, recruitment pending), Spain (authorised, recruitment pending), Sweden (authorised, recruitment pending), Italy (authorised, recruitment pending), Denmark (authorised, recruitment pending), Netherlands (authorised, recruitment pending), Belgium (authorised, recruitment pending).
Therapeutic area(s): Diseases [C] - Neoplasms [C04]
Gender: Female, Male. Age: 18-64 years, 65+ years. Enrolment: 49.
Status: Authorised, recruitment pending. Decision date: 2026-06-08. Results received: No. Last updated: 2026-06-12.
Decision dates by country: SE: 2026-06-08, NL: 2026-06-08, IT: 2026-06-09, ES: 2026-06-12, BE: 2026-06-12, FI: 2026-06-08, DK: 2026-06-08

Condition(s): adenocarcinoma of the colon or rectum

Source: https://euclinicaltrials.eu/ctis-public/view/2025-523648-11-00